EU clinical trial 2024-517206-28-00: Effect of intravenous ferric carboxymaltose on mortality and cardiovascular morbidity, and quality of life in iron deficient patients with recent myocardial infarction
Protocol code: 2019/ABM/01/00081
Sponsor: Wroclaw Medical University (Educational Institution). Phase: Therapeutic use (Phase IV). Countries: Poland (ongoing, recruiting).
Therapeutic area(s): Diseases [C] - Cardiovascular Diseases [C14]
Gender: Female, Male. Age: 18-64 years, 65+ years. Enrolment: 1000.
Status: Ongoing, recruiting. Start date (EU): 2022-09-21. Decision date: 2024-11-18. Results received: No. Last updated: 2026-06-11.

Condition(s): Recent myocardial infarction associated with iron deficient
Product: Ferinject 50 mg żelaza/ml dyspersja do wstrzykiwań/infuzji, 0,9% Sodium Chloride–Braun, 9 mg/ml, roztwór do infuzji

Primary endpoint: 1) Time to all-cause death assessed up to maximum 36-months follow-up;, 2) Number of HFE assessed up to maximum 36-months follow-up;, 3) Time to first HFE assessed up to maximum 36-months follow-up;, 4) Changes in serum NT-proBNP concentration from the start of the follow-up to the end of participation in the study assessed as the area under the curve;, 5) Changes in quality of life (QoL) measured using the EQ-5D questionnaire from the start of the follow-up to the end of participation in the study assessed as the area under the curve.
Endpoint(s): First unplanned HF hospitalisation or unplanned visit at emergency department due to HF or CV death during the follow-up (time-to-event model)., All unplanned HF hospitalisations and unplanned visit at emergency department due to HF and CV death during the follow-up (recurrent event model)., All unplanned HF hospitalisations and unplanned visit at emergency department due to HF during the follow-up (recurrent event model)., All unplanned HF hospitalisations during the follow-up (recurrent event model)., CV death during thefollow-up.

Source: https://euclinicaltrials.eu/ctis-public/view/2024-517206-28-00